EU clinical trial 2023-503190-38-00: Metformin add-on clinical study in multiple sclerosis to evaluate brain remyelination and neurodegeneration: a phase IIb triple-blind placebo-controlled randomized clinical trial (MACSiMiSE-BRAIN)
Protocol code: MACSiMiSE-BRAIN_v1.0
Sponsor: Antwerp University Hospital (Hospital/Clinic/Other health care facility). Phase: Therapeutic exploratory (Phase II). Countries: Belgium (ongoing, recruitment ended).
Therapeutic area(s): Diseases [C] - Nervous System Diseases [C10]
Gender: Female, Male. Age: 18-64 years, 65+ years. Enrolment: 120.
Status: Ongoing, recruitment ended. Start date (EU): 2023-11-23. Decision date: 2023-04-24. Results received: No. Last updated: 2026-02-04.

Condition(s): Progressive Multiple Sclerosis
Product: Metformin AL 850 mg Filmtabletten, Gilenya 0.5 mg hard capsules, Mayzent 1 mg film-coated tablets, Ponvory 20 mg film-coated tablets, Glatiramyl 20 mg/ml oplossing voor injectie in een voorgevulde spuit, Tecfidera 240 mg gastro-resistant hard capsules, Metformin STADA® 850 mg Filmtabletten, Copaxone 40 mg/ml oplossing voor injectie in een voorgevulde spuit., The placebo will be manufactured based on the metformin hydrochloride 850 mg (metformin ALIUD® 850 mg) specifications to match the characteristics (appearance, size) of the imp, without containing the active ingredient (see impd)., Betaferon 250 microgram/ml, powder and solvent for solution for injection, Copaxone 20 mg/ml oplossing voor injectie in een voorgevulde spuit., AUBAGIO 14 mg film-coated tablets, Plegridy 125 micrograms solution for injection in pre-filled syringe, Zeposia 0.92 mg hard capsules, The placebo will be manufactured based on the Metformin Hydrochloride 850 mg (Metformin STADA® 850 mg) specifications to match the characteristics (appearance, size) of the IMP, without containing the active ingredient (see IMPD)., Mayzent 2 mg film-coated tablets, AVONEX 30 micrograms/0.5 ml solution for injection., Ocrevus 300 mg concentrate for solution for infusion, Rebif 22 micrograms solution for injection in pre-filled syringe, TYSABRI 300 mg concentrate for solution for infusion, Kesimpta 20 mg solution for injection in pre-filled syringe, Glatiramyl 40 mg/ml, oplossing voor injectie in een voorgevulde spuit

Primary endpoint: Change in walking speed, measured by T25FW, between baseline and 96 weeks of treatment.
Endpoint(s): Change in Expanded Disability Status Scale (EDSS) between baseline and after 96 weeks of treatment., Change in cognitive function as measured by Symbol Digit Modalities Test (SDMT) between baseline and 96 weeks of treatment., Change in hand function as measured by Nine-Hole Peg Test (9HPT) between baseline and 96 weeks of treatment., Change in the Compisite endpoint as measured by Overall Disability Response Score (ODRS) between baseline and 96 weeks of treatment., Change in 2 minute walk test between baseline and 96 weeks of treatment., Change in brain volume (whole brain volume and gray matter volume) as measured by MRI from baseline to 48 weeks, from baseline to 96 weeks and from 48 to 96 weeks., Change in brain MRI-DTI metrics (fractional anisotropy (FA), mean diffusivity (MD) and radial diffusivity (RD)) from baseline to 48 weeks, from baseline to 96 weeks and from 48 to 96 weeks, Change in quality of life as measured by EQ-5D-5L between baseline and 96 weeks of treatment., Change in quality of life as measured by Multiple Sclerosis Impact Scale-29 between baseline and 96 weeks of treatment., Change in number of SWI lesions from baseline to 48 weeks, from baseline to 96 weeks and from 48 to 96 weeks., Change in Modified Caregiver strain index (MCSI) from baseline to 96 weeks., Average total costs between baseline and 96 weeks of treatment and incremental cost-effectiveness ratio

Source: https://euclinicaltrials.eu/ctis-public/view/2023-503190-38-00